EU clinical trial 2024-512617-41-00: A Phase 1, Open-Label, Non-Randomized, Single-Center, Single-Dose Study to Assess the Pharmacokinetics and Safety of ANT3310 Combined with Meropenem Administered as a Single Intravenous Infusion to Adult Subjects with Renal Function Impairment
Protocol code: ANT3310-SP-002-V01
Sponsor: Antabio (Pharmaceutical company). Phase: Human Pharmacology (Phase I)- Other. Countries: Germany (ended).
Therapeutic area(s): Diseases [C] - Bacterial Infections and Mycoses [C01]
Gender: Female, Male. Age: 18-64 years, 65+ years. Enrolment: 48.
Status: Ended. Start date (EU): 2024-07-19. End date (EU): 2025-07-10. Decision date: 2024-06-12. Results received: No. Last updated: 2025-05-20.

Condition(s): Renal impairment

Source: https://euclinicaltrials.eu/ctis-public/view/2024-512617-41-00